EU clinical trial 2023-504011-33-00: A Single Dose, Fast State, Bioequivalence Study of CEFIXIMA ATB 400 mg Hard Capsules (Antibiotice S.A.) vs. CEFIXORAL® 400 mg Film Coated Tablets (A. Menarini Industrie Farmaceutiche Riunite s.r.l.)
Protocol code: CEFIAIS 01/2022
Sponsor: Antibiotice S.A. (Pharmaceutical company). Phase: Human Pharmacology (Phase I)- Bioequivalence Study. Countries: Romania (ended).
Therapeutic area(s): Diseases [C] - Respiratory Tract Diseases [C08]; Diseases [C] - Digestive System Diseases [C06]; Diseases [C] - Otorhinolaryngologic Diseases [C09]; Diseases [C] - Bacterial Infections and Mycoses [C01]
Gender: Female, Male. Age: 18-64 years. Enrolment: 28.
Status: Ended. Start date (EU): 2023-06-12. End date (EU): 2023-07-02. Decision date: 2023-05-17. Results received: Yes. Last updated: 2023-05-17.

Condition(s): healthy subjects
Product: CEFIXORAL 400 mg compresse rivestite, Cefixima Atb 400mg

Primary endpoint: Pharmacokinetics • Cmax, AUClast, AUCtotal
Endpoint(s): a. pharmacokinetics • Tmax, thalf, kel and Residual area., Safety endpoints include, but are not limited to, adverse events (AEs), (including serious adverse events [SAEs], severe AEs, and AEs leading to discontinuation of the study drug), and clinically significant changes from baseline in vital sign measurements, and clinical laboratory test results

Source: https://euclinicaltrials.eu/ctis-public/view/2023-504011-33-00